EU clinical trial 2024-515323-11-00: Prevention of cardiac Dysfunction during Adjuvant breast cancer therapy: A Randomized, Placebo-controlled, Multicenter Trial (PRADA-II)
Protocol code: PRADA II
Sponsor: Akershus University Hospital (Hospital/Clinic/Other health care facility). Phase: Therapeutic exploratory (Phase II). Countries: Norway (ongoing, recruitment ended).
Therapeutic area(s): Diseases [C] - Cardiovascular Diseases [C14]; Diseases [C] - Neoplasms [C04]
Gender: Female. Age: 18-64 years, 65+ years. Enrolment: 214.
Status: Ongoing, recruitment ended. Start date (EU): 2024-11-13. Decision date: 2024-11-13. Results received: No. Last updated: 2026-02-04.

Condition(s): Heart Failure, Breast cancer female
Product: Entresto 49 mg/51 mg film-coated tablets, Entresto 49 mg/51 mg film-coated tablets, Entresto 49 mg/51 mg film-coated tablets, Entresto 49 mg/51 mg film-coated tablets, Entresto 97 mg/103 mg film-coated tablets, Entresto 97 mg/103 mg film-coated tablets, Entresto 97 mg/103 mg film-coated tablets, Entresto 24 mg/26 mg film-coated tablets, Entresto 49 mg/51 mg film-coated tablets, Entresto 24 mg/26 mg film-coated tablets, Entresto 97 mg/103 mg film-coated tablets, Entresto 24 mg/26 mg film-coated tablets, Entresto 24 mg/26 mg film-coated tablets, Entresto 24 mg/26 mg film-coated tablets, Placebo to sacubitril/valsartan (lcz696) 50 mg film coated tablet, Entresto 49 mg/51 mg film-coated tablets, Entresto 97 mg/103 mg film-coated tablets, Entresto 97 mg/103 mg film-coated tablets, Placebo to sacubitril/valsartan (lcz696) 200 mg film coated tablet, Entresto 49 mg/51 mg film-coated tablets, Placebo to sacubitril/valsartan (lcz696) 100mg film coated tablet, Entresto 97 mg/103 mg film-coated tablets, Entresto 24 mg/26 mg film-coated tablets, Entresto 97 mg/103 mg film-coated tablets, Entresto 49 mg/51 mg film-coated tablets

Primary endpoint: Change in left ventricular ejection fraction (LVEF), as determined by CMR from randomization to end of blinded therapy (18 months).
Endpoint(s): Change in left ventricular ejection fraction (LVEF), as determined by echocardiography from randomization to end of blinded therapy (18 months)., Change in global longitudinal strain (GLS), as determined by echocardiography from randomization to end of blinded therapy (18 months)., Change in GLS, as determined by CMR from randomization to end of blinded therapy (18 months), Change in end-systolic volume measured by CMR., Incidence of clinically significant reduction in left ventricular systolic function expressed as an absolute reduction in LVEF >/=5% by CMR., Incidence of clinically significant reduction in left ventricular systolic function expressed as a relative percentage reduction of GLS > 15%, Incidence of cardiotoxicity expressed as an absolute reduction in LVEF >/=10% to a value below 50% as measured either by CMR or Echocardiography., Incidence of cardiotoxicity expressed as incidence of clinical heart failure., Cardiotoxic injury expressed as change in circulating concentrations of cardiac troponins I and T measured by high sensitivity assays (hs-TnI and hs-TnT) and N-terminal proB-type natriuretic peptide (NT-proBNP).

Source: https://euclinicaltrials.eu/ctis-public/view/2024-515323-11-00